EU clinical trial 2025-523977-40-00: Changes in Coronary Plaque Composition By Semaglutide Use in Diabetic Patients With Acute Coronary Syndrome: A Randomized Optical Coherence Tomography Trial - ARMYDA - 10 study
Protocol code: ARMYDA - 10
Sponsor: Azienda Ospedaliero-Universitaria Maggiore Della Carita (Hospital/Clinic/Other health care facility). Phase: Therapeutic use (Phase IV). Countries: Italy (authorised, recruitment pending).
Therapeutic area(s): Diseases [C] - Cardiovascular Diseases [C14]
Gender: Female, Male. Age: 18-64 years, 65+ years. Enrolment: 90.
Status: Authorised, recruitment pending. Decision date: 2026-01-28. Results received: No. Last updated: 2026-01-28.

Condition(s): non-ST-elevation myocardial infarction (NSTEMI); unstable angina, diabetes mellitus
Product: Rybelsus 3 mg tablets

Primary endpoint: the change of the maximum macrophage arc (degrees) in non-culprit coronary stenoses from baseline to 24 weeks, measured by OCT, in the semaglutide vs control arm
Endpoint(s): changes from baseline to 24 weeks in OCT parameters (lumen area, plaque volume, fibrous cap thickness, lipid/calcium arcs and lengths), plaque composition (fibrous, fibro-calcific, fibro-atheroma, TCFA), prevalence of healed and macrophage-rich plaques, HbA1c, BMI, and incidence of cardiovascular events and adverse effects.

Source: https://euclinicaltrials.eu/ctis-public/view/2025-523977-40-00